EU clinical trial 2024-513664-25-00: Phase I Study of Plitidepsin Administered Intravenously as a Single Dose in Healthy Volunteers
Protocol code: HV-APL-A-001-24
Sponsor: Pharma Mar S.A. (Pharmaceutical company). Phase: Human Pharmacology (Phase I)- Other. Countries: Spain (ongoing, recruitment ended).
Therapeutic area(s): Diseases [C] - Virus Diseases [C02]
Gender: Female, Male. Age: 18-64 years. Enrolment: 60.
Status: Ongoing, recruitment ended. Start date (EU): 2026-01-26. Decision date: 2025-03-10. Results received: No. Last updated: 2026-01-26.

Condition(s): Virus diseases

Source: https://euclinicaltrials.eu/ctis-public/view/2024-513664-25-00